EU clinical trial 2023-504280-16-00: A study to investigate JNJ-80202135 (nipocalimab) delivered subcutaneously via prefilled syringe autoinjector and via normal syringe
Sponsor: Janssen - Cilag International (Pharmaceutical company). Phase: Human Pharmacology (Phase I)- Other. Countries: Belgium (ended).
Therapeutic area(s): Diseases [C] - Immune System Diseases [C20]
Gender: Female, Male. Age: 18-64 years. Enrolment: 60.
Status: Ended. Start date (EU): 2023-10-17. End date (EU): 2024-03-18. Decision date: 2023-10-10. Results received: No. Last updated: 2024-02-06.

Condition(s): Healthy Volunteers

Source: https://euclinicaltrials.eu/ctis-public/view/2023-504280-16-00